EU clinical trial 2023-508518-40-00: A Study to Learn If the Study Medicine Called Vepdegestrant Changes How the Body Processes the Other Study Medicine Called Midazolam
Sponsor: Pfizer Inc. (Pharmaceutical company). Phase: Human Pharmacology (Phase I)- Other. Countries: Belgium (ended).
Therapeutic area(s): Diseases [C] - Neoplasms [C04]
Gender: Female. Age: 18-64 years, 65+ years. Enrolment: 16.
Status: Ended. Start date (EU): 2024-02-05. End date (EU): 2024-05-13. End date: 2024-05-14. Decision date: 2024-01-31. Results received: No. Last updated: 2024-01-31.

Condition(s): ER+/HER2 positive breast cancer

Source: https://euclinicaltrials.eu/ctis-public/view/2023-508518-40-00